EU clinical trial 2022-501688-42-00: Evaluation of diagnostic performances of 18F-FDOPA PET KInetics as biomarkers for the improvement of care of MRI Non-contrast enhanced Gliomas : a phase IIIb exploratory trial
Protocol code: 2021PI203
Sponsor: Centre Hospitalier Regional Universitaire De Nancy (Hospital/Clinic/Other health care facility). Phase: Therapeutic confirmatory (Phase III). Countries: France (ongoing, recruiting).
Therapeutic area(s): Diseases [C] - Nervous System Diseases [C10]
Gender: Female, Male. Age: 18-64 years, 65+ years. Enrolment: 88.
Status: Ongoing, recruiting. Start date (EU): 2023-05-24. Decision date: 2023-04-14. Results received: No. Last updated: 2025-08-25.

Condition(s): Low Grade Glioma
Product: Dopacis 90 MBq/mL, solution injectable

Primary endpoint: The primary endpoints are: the sensitivity, specificity, predictive positive value (PPV) and negative predictive value (NPV) of the 18F-FDOPA kinetic TTP parameter, to characterise aggressive lesions within suspected LGGs with no contrast enhancement on MRI at the initial diagnosis.
Endpoint(s): Sensitivity, specificity, PPV and NPV of the 18F-FDOPA kinetic “slope” parameter., Sensitivity, specificity, PPV and NPV of the 18F-FDOPA SUV conventional parameters (SUVmax, SUVmean and SUVpeak) and/or radiomics analysis (with the best predictive radiomics model) associated to the TTP kinetic parameter., Proportion of aggressive lesions expressed as an instantaneous prevalence and its 95% confidence interval of the total number of suspected LGGs without any contrast enhancement on MRI examined at initial diagnosis and referred for biopsy or surgery within the following 6 months, Number of patients who need to be diagnosed with 18F-FDOPA kinetic parameter TTP to identify an aggressive lesion within the suspected LGG population that do not exhibit any contrast enhancement on MRI at initial diagnosis and that undergo biopsy/surgery, defined as: 1/ [% of aggressive lesions detected with the 18F-FDOPA TTP parameter].

Source: https://euclinicaltrials.eu/ctis-public/view/2022-501688-42-00